EU clinical trial 2025-522495-84-00: A Clinical study of MK-4716 in people with certain solid tumors (MK-4716-001)
Protocol code: MK-4716-001
Sponsor: Merck Sharp & Dohme LLC (Pharmaceutical company). Phase: Phase I and Phase II (Integrated)- First administration to humans. Countries: Spain (ongoing, recruiting).
Therapeutic area(s): Diseases [C] - Neoplasms [C04]
Gender: Female, Male. Age: 18-64 years, 65+ years. Enrolment: 29.
Status: Ongoing, recruiting. Start date (EU): 2026-01-14. Decision date: 2025-12-23. Results received: No. Last updated: 2026-05-05.

Condition(s): Cancer – Solid Tumors : 1L NSCLC and all other advanced or metastatic solid tumors with KRAS alterations (KRAS mutation or KRAS amplification)

Source: https://euclinicaltrials.eu/ctis-public/view/2025-522495-84-00